EU clinical trial 2024-515036-71-00: Accelerator-based BNCT for head and neck carcinoma
Protocol code: HN-BNCT-01-2024
Sponsor: HUS-Yhtymae, Neutron Therapeutics Finland Oy (Hospital/Clinic/Other health care facility, Pharmaceutical company). Phase: Human Pharmacology (Phase I)- Other. Countries: Finland (ended).
Therapeutic area(s): Diseases [C] - Pathological Conditions, Signs and Symptoms [C23]
Gender: Female, Male. Age: 18-64 years, 65+ years. Enrolment: 10.
Status: Ended. Start date (EU): 2025-04-15. End date (EU): 2026-04-16. Decision date: 2024-10-16. Results received: No. Last updated: 2026-04-21.

Condition(s): Head and neck carcinoma

Source: https://euclinicaltrials.eu/ctis-public/view/2024-515036-71-00